EU clinical trial 2024-514745-10-00: A Study of PF-08046031 in Adults With Advanced Melanoma and Other Solid Tumors
Protocol code: C5901001
Sponsor: Pfizer Inc. (Pharmaceutical company). Phase: Human Pharmacology (Phase I)- First administration to humans. Countries: Germany (ended), Sweden (ended), France (ended), Netherlands (ended), Spain (ended).
Therapeutic area(s): Diseases [C] - Neoplasms [C04]
Gender: Female, Male. Age: 18-64 years, 65+ years. Enrolment: 58.
Status: Ended. Start date (EU): 2025-06-23. End date (EU): 2025-10-20. End date: 2026-02-23. Decision date: 2025-05-21. Results received: No. Last updated: 2025-06-06.
Decision dates by country: DE: 2025-05-21, ES: 2025-05-22, SE: 2025-05-26, NL: 2025-05-26, FR: 2025-05-23

Condition(s): Melanoma (or) malignant melanoma; Non-small cell lung cancer; Head and neck squamous cell carcinoma; Esophageal cancer

Source: https://euclinicaltrials.eu/ctis-public/view/2024-514745-10-00